EU clinical trial 2023-506763-33-00: A Phase 2, Multicenter, Randomized, Double-blind, Placebo‑controlled Study with Deferred Active Treatment to Investigate the Efficacy, Safety, and Pharmacokinetics of JNJ‑73763989 + Nucleos(t)ide Analog in Participants Co‑infected with Hepatitis B and Hepatitis D Virus
Sponsor: Janssen - Cilag International (Pharmaceutical company). Phase: Therapeutic exploratory (Phase II). Countries: Sweden (ended), Italy (ended), France (ended).
Therapeutic area(s): Diseases [C] - Virus Diseases [C02]
Gender: Female, Male. Age: 18-64 years. Enrolment: 14.
Status: Ended. Start date (EU): 2020-12-18. End date (EU): 2025-01-15. End date: 2025-03-05. Decision date: 2024-02-08. Results received: Yes. Last updated: 2024-09-02.
Decision dates by country: FR: 2024-02-08, IT: 2024-02-12, SE: 2024-02-08

Condition(s): Hepatitis B and Hepatitis D Viral Co-infection
Product: TENOFOVIR ALAFENAMIDE, Sodium chloride solution 0.9%, ENTECAVIR, TENOFOVIR DISOPROXIL, JNJ-73763989

Primary endpoint: Proportion of participants with HDV RNA ≥2 log10 IU/mL decline from baseline or HDV RNA TND in combination with normal ALT levels at Week 48.

Source: https://euclinicaltrials.eu/ctis-public/view/2023-506763-33-00